EU clinical trial 2023-509631-37-00: A Phase 3, Open-label, Randomized Study of Dato-DXd Versus Investigator’s Choice of Chemotherapy in Participants With Inoperable or Metastatic Hormone Receptor-Positive, HER2-Negative Breast Cancer Who Have Been Treated With One or Two Prior Lines of Systemic Chemotherapy (TROPION-Breast01)
Protocol code: D9268C00001
Sponsor: AstraZeneca AB (Pharmaceutical company). Phase: Therapeutic confirmatory (Phase III). Countries: Spain (ended), France (ongoing, recruitment ended), Germany (ended), Poland (ended), Italy (ended), Belgium (ended), Hungary (ended).
Therapeutic area(s): Diseases [C] - Neoplasms [C04]
Gender: Female, Male. Age: 18-64 years, 65+ years. Enrolment: 253.
Start date (EU): 2022-01-18. Decision date: 2024-06-19. Results received: No. Last updated: 2026-03-02.
Decision dates by country: BE: 2024-06-19, HU: 2024-06-19, ES: 2024-06-21, IT: 2024-06-24, PL: 2024-07-24, DE: 2024-06-24, FR: 2024-06-24

Condition(s): "Inoperable or Metastatic Hormone Receptor-Positive, HER2-Negative Breast Cancer that Have Been Treated With One or Two Prior Lines of Systemic Chemotherapy"
Product: ERIBULIN MESYLATE, VINORELBINE, GEMCITABINE, CAPECITABINE, CAPECITABINE, Datopotamab deruxtecan

Primary endpoint: PFS is defined as time from randomization until progression per RECIST 1.1, as assessed by BICR, or death due to any cause. The analysis will include all randomized participants as randomized regardless of whether the participant withdraws from therapy, receives another anti-cancer therapy, or clinically progresses prior to RECIST 1.1. The measure of interest is the hazard ratio of PFS., OS is defined as time from randomization until the date of death due to any cause. The comparison will include all randomized participants as randomized, regardless of whether the participant withdraws from therapy or receives another anti-cancer therapy. The measure of interest is the hazard ratio of OS
Endpoint(s): 1. Objective Response Rate: Objective response rate is defined as the proportion of participants who have a confirmed CR or PR, as determined by the BICR/Investigator assessment, per RECIST 1.1., 2. Duration of Response: Duration of response is defined as the time from the date of first documented confirmed response until date of documented progression per RECIST 1.1, as assessed by BICR/Investigator assessment or death due to any cause., 3. Progression-Free Survival by Investigator assessment: PFS by Investigator assessment will be defined as the time from the date of randomization until the date of PD per RECIST 1.1 (by Investigator assessment) or death (by any cause in the absence of progression), (ie, date of event or censoring – date of randomization + 1)., 4. Disease Control Rate: Disease control rate at 12 weeks is defined as the percentage of participants who have a confirmed CR or PR or who have SD, per RECIST 1.1, as assessed BICR/per investigator assessment and derived from the raw tumor data for at least 11 weeks after randomization., 5. Time to First Subsequent Therapy (TFST): Time to first subsequent therapy is defined as the time from randomization until the start date of the first subsequent anti-cancer therapy after discontinuation of randomized treatment, or death due to any cause., 6. Time to Second Subsequent Therapy (TSST): Time to second subsequent therapy is defined as the time from randomization to until the start date of the second subsequent anti-cancer therapy after discontinuation of first subsequent treatment, or death due to any cause., 7. Time from randomization to second progression or death (PFS2): Time to second progression of death will be defined as the time from the randomization to the earliest of the progression event (following the initial progression), subsequent to first subsequent therapy, or death. The date of second progression will be recorded by the Investigator in the eCRF and defined according to local standard clinical practice., 8. Clinical Outcome Assessments:The secondary PRO endpoints include:TTD in pain as measured by the pain scale from EORTC QLQ-C30, TTD in physical functioning as measured by the physical functioning scale from EORTC QLQ-C30, TTD in GHS/QoL as measured by the GHS/QoL scale from EORTC QLQ-C30, 9. Pharmacokinetics, 10. Immunogenicity

Source: https://euclinicaltrials.eu/ctis-public/view/2023-509631-37-00